EU clinical trial 2025-521353-16-00: A Phase 3 Extension Study of siRNA Targeting of Prekallikrein With ADX-324 in Participants With Hereditary Angioedema
Protocol code: ADX-324-302
Sponsor: Adarx Pharmaceuticals Inc. (Pharmaceutical company). Phase: Therapeutic confirmatory (Phase III). Countries: Poland (authorised, recruitment pending), Italy (authorised, recruitment pending), Hungary (authorised, recruitment pending), France (authorised, recruitment pending), Austria (authorised, recruitment pending), Czechia (authorised, recruitment pending), Belgium (authorised, recruitment pending), Spain (authorised, recruitment pending), Bulgaria (authorised, recruitment pending), Germany (authorised, recruitment pending), Croatia (authorised, recruitment pending).
Therapeutic area(s): Diseases [C] - Immune System Diseases [C20]
Gender: Female, Male. Age: 18-64 years, 65+ years. Enrolment: 45.
Status: Authorised, recruitment pending. Decision date: 2026-06-22. Results received: No. Last updated: 2026-07-31.
Decision dates by country: AT: 2026-06-29, BE: 2026-06-24, HR: 2026-06-26, DE: 2026-06-24, HU: 2026-06-23, ES: 2026-06-26, PL: 2026-06-29, BG: 2026-06-22, CZ: 2026-07-21, FR: 2026-06-26, IT: 2026-06-23

Condition(s): Hereditary Angioedema
Product: ADX-324, Sterile normal saline (0.9% sodium chloride solution)

Primary endpoint: Incidence and severity of TEAEs.
Endpoint(s): The time-normalized number of Investigator-confirmed HAE attacks (per month), The time-normalized number of Investigator-confirmed HAE attacks requiring acute HAE therapy (per month), The -normalized number of moderate or severe Investigator confirmed HAE attacks (per month), The proportion of participants who have not experienced an Investigator-confirmed HAE attack (HAE attack-free)

Source: https://euclinicaltrials.eu/ctis-public/view/2025-521353-16-00